EU clinical trial 2024-512744-32-00: C4951003 - Phase 3, multicenter, open-label study to assess the long-term safety and tolerability of rimegepant for the acute treatment of migraine (with or without aura) in children and adolescents ≥ 6 to < 18 years of age
Protocol code: C4951003
Sponsor: Pfizer Inc. (Pharmaceutical company). Phase: Therapeutic confirmatory (Phase III). Countries: Poland (ongoing, recruiting), Spain (ongoing, recruiting).
Therapeutic area(s): Diseases [C] - Nervous System Diseases [C10]
Gender: Female, Male. Age: 0-17 years. Enrolment: 98.
Status: Ongoing, recruiting. Start date (EU): 2022-02-01. Decision date: 2024-06-21. Results received: No. Last updated: 2026-06-01.
Decision dates by country: ES: 2024-06-21, PL: 2024-07-24

Condition(s): Acute Migraine (with or without aura)
Product: 35 mg oral lyophilisate, 50 mg oral lyophilisate, 25 mg oral lyophilisate, VYDURA 75 mg oral lyophilisate

Primary endpoint: The frequency and severity of on-treatment and treatment-emergent adverse events (TEAEs) that occur in at least 5% of treated participants, the frequency of serious adverse events (SAEs) , adverse events (AEs) leading to discontinuation and clinically significant laboratory abnormalities during the treatment period will be assessed. Clinically significant laboratory abnormalities will be identified as on-treatment Grade 3 to 4 laboratory test results.
Endpoint(s): The frequency and severity of hepatic-related adverse events (AEs) and frequency of hepatic-related AEs leading to treatment discontinuation will be tabulated from case report forms and will be based on unique participants reporting such events. Severity will be assessed as the worst severity observed while the participant is on treatment.

Source: https://euclinicaltrials.eu/ctis-public/view/2024-512744-32-00